EU clinical trial 2025-522955-25-00: Next Generation StaR TREC - Save the rectum by watchful waiting after (chemo)Radiotherapy or Total mesorectal excision for early REctal Cancer?
Sponsor: Vaestra Goetalandsregionen (Hospital/Clinic/Other health care facility). Phase: Therapeutic use (Phase IV). Countries: Sweden (authorised, recruitment pending).
Therapeutic area(s): Diseases [C] - Neoplasms [C04]
Gender: Female, Male. Age: 18-64 years, 65+ years. Enrolment: 80.
Status: Authorised, recruitment pending. Decision date: 2026-01-09. Results received: No. Last updated: 2026-05-06.

Condition(s): Rectal cancer
Product: Capecitabine Orion 500 mg filmdragerade tabletter

Primary endpoint: Ratio of patients with a non-operative approach at onset that after evaluation by a combination of MRI, clinical and endoscopic examination have a clinical complete response at 1 year.
Endpoint(s): Local recurrence, Local regrowth, Survival (overall), Metastases, Organ preservation rate, Clinical complete response rate, Morbidity measured with Comprehensive Complications Classification Index (41), Total length of hospital stay, Radical resection (R0) after surgery, Urinary function, Sexual function, Bowel function, Presence of a stoma

Source: https://euclinicaltrials.eu/ctis-public/view/2025-522955-25-00